EU clinical trial 2025-521578-32-00: A Randomized, Multicenter, Double-Blind, Parallel-Group, Placebo- and Active-Controlled Phase III Therapeutic Superiority Trial Comparing the Efficacy and Tolerability of a Fixed-Dose Combination of Diclofenac + Orphenadrine + Paracetamol to Diclofenac (Cataflam®) and Orphenadrine + Paracetamol (Norgesic®) in Patients with Acute Severe Low Back Pain.
Protocol code: DI-OR-PA
Sponsor: Verisfield Single Member S.A. (Pharmaceutical company). Phase: Therapeutic confirmatory (Phase III). Countries: Greece (ongoing, recruiting).
Therapeutic area(s): Diseases [C] - Musculoskeletal Diseases [C05]
Gender: Female, Male. Age: 18-64 years. Enrolment: 224.
Status: Ongoing, recruiting. Start date (EU): 2026-04-05. Decision date: 2025-09-25. Results received: No. Last updated: 2026-03-19.

Condition(s): LOW BACK PAIN
Product: CATAFLAM Sugar Coated Tablets 50mg, Placebo Red, Diclofenac + Orphenadrine + Paracetamol / Verisfield film-coated tablets, DEPON 500 mg δισκίο, Norgesic 35 mg / 450 mg δισκία, Placebo White

Primary endpoint: The primary endpoint is the cumulative, time-weighted sum of pain intensity differences (SPID), expressed as the sum of seven daily SPIDs from 0 to 6 hours post-dose (SPID0-6h) across the 7-day treatment period, compared between groups.
Endpoint(s): Average analgesic effect: The daily SPID0-6h for each one of the 7 treatment days, compared between groups., Rescue medication use: Mean number of rescue medication tablets consumed per participant from baseline to day 7 compared between groups., Responder rate: Proportion of patients achieving mild pain (e.g., VAS <45 mm) by day 7 compared between groups., Safety and tolerability: Incidence and proportion of participants experiencing adverse events throughout the study period compared between groups., Functional improvement: Mean percent change in Finger-to-Floor Distance (FFD) test score from baseline to day 7 compared between groups.

Source: https://euclinicaltrials.eu/ctis-public/view/2025-521578-32-00